EU clinical trial 2023-504277-20-00: A Randomized, Double-Blind, Parallel-Group, Placebo-Controlled Phase 3 Efficacy and Safety Study of Tezepelumab in Patients with Eosinophilic Esophagitis (CROSSING)
Protocol code: CROSSING
Sponsor: AstraZeneca AB (Pharmaceutical company). Phase: Therapeutic confirmatory (Phase III). Countries: Greece (ongoing, recruitment ended), Belgium (ongoing, recruitment ended), Denmark (ended), Germany (ongoing, recruitment ended), Spain (ongoing, recruitment ended), Austria (ended), Netherlands (ongoing, recruitment ended), Slovakia (ended), Italy (ongoing, recruitment ended), Czechia (ended), Finland (ended), Norway (ongoing, recruitment ended), Sweden (ongoing, recruitment ended).
Therapeutic area(s): Diseases [C] - Immune System Diseases [C20]
Gender: Female, Male. Age: 0-17 years, 18-64 years, 65+ years. Enrolment: 211.
Start date (EU): 2023-01-30. Decision date: 2024-06-24. Results received: No. Last updated: 2026-04-09.
Decision dates by country: FI: 2024-06-24, DK: 2024-06-24, AT: 2024-08-05, NL: 2024-06-24, DE: 2024-06-24, CZ: 2024-07-01, BE: 2024-06-25, SK: 2024-06-24, ES: 2024-06-26, GR: 2024-08-02, NO: 2024-06-24, SE: 2024-06-24, IT: 2024-07-01

Condition(s): Eosinophilic esophagitis (EoE) is a rare, chronic inflammatory disorder triggered by an immune response to foods and aeroantigens and characterized by a combination of esophageal dysfunction and eosinophilic infiltration of the esophagus
Product: Tezspire 210 mg solution for injection in pre-filled syringe, Tezepelumab-placebo

Primary endpoint: 1. Histologic response of peak esophageal eosinophil per HPF count of ≤ 6 across all available esophageal levels at Week 24, 2. Change from baseline in DSQ score at Week 24
Endpoint(s): 1. Change from baseline in EoE EREFS at Week 24 and Week 52, 2. Change from baseline in EoE-HSS grade score at Week 24 and Week 52, 3. Change from baseline in EoE-HSS stage score at Week 24 and Week 52, 4. Histologic response of peak esophageal eosinophil per HPF count of ≤ 6 across all available esophageal levels at Week 52, 5. Change from baseline in DSQ score at Week 52, 6. Endoscopic response of total EREFS score of 0 to ≤ 2 with no score > 1 for any of the components and no worsening in any individual component from baseline across all esophageal levels (ie, proximal, mid, and distal) at Week 52, 7. Endoscopic inflammatory remission of EREFS inflammatory subscore (including edema, exudate, and furrows components) of 0 with no worsening in rings or stricture from baseline across all esophageal levels at Week 52., 8. Total endoscopic remission of total EREFS score of 0 across all esophageal levels at Week 52., 9. Change from baseline in peak esophageal eosinophil count (EOS/HPF) at Week 24 and Week 52, 10. Changes from baseline in PEESS Module at Week 24 and Week 52 (adolescents only), 11. Serum trough concentrations at Weeks 0, 4, 12, and 52, 12. Anti-drug antibody at Weeks 0, 12, 24, and 52

Source: https://euclinicaltrials.eu/ctis-public/view/2023-504277-20-00